EU clinical trial 2024-517832-23-00: Prospective, multicentre phase II study of de-escalation of primary chemoradiotherapy of squamous cell carcinoma of oropharynx (OPC) associated with human papilloma virus (HPV)
Protocol code: NADEJ201901
Sponsor: Vychodoslovensky Onkologicky Ustav a.s. (Hospital/Clinic/Other health care facility). Phase: Therapeutic exploratory (Phase II). Countries: Slovakia (ongoing, recruitment ended).
Therapeutic area(s): Diseases [C] - Neoplasms [C04]
Gender: Female, Male. Age: 18-64 years, 65+ years. Enrolment: 100.
Status: Ongoing, recruitment ended. Start date (EU): 2020-01-09. Decision date: 2024-11-04. Results received: No. Last updated: 2024-11-04.

Condition(s): Human Papillomavirus oropharyngeal squamous cell carcinoma
Product: CISPLATIN

Primary endpoint: Two-year locoregional control
Endpoint(s): Primary loco-regional control after initial intervention and CRT, Overall survival, Disease-specific survival, Survival without disease, Percentage of distant metastases, Adverse effects, Influencing QoL, Reliability and validity of biomarker p16, Difference in OPC-associated HPV molecular profile in non-smokers and smokers

Source: https://euclinicaltrials.eu/ctis-public/view/2024-517832-23-00